EU clinical trial 2025-521372-62-00: Safety and Feasibility of a Venetoclax- Augmented Treosulfan-Based Reduced Intensity Conditioning before Allogeneic Stem Cell Transplantation in AML, MDS/AML and higher risk MDS (Vestal)
Protocol code: Vestal
Sponsor: Universitaetsklinikum Tuebingen AöR (Hospital/Clinic/Other health care facility). Phase: Therapeutic exploratory (Phase II). Countries: Germany (ongoing, recruiting).
Therapeutic area(s): Diseases [C] - Hemic and Lymphatic Diseases [C15]
Gender: Female, Male. Age: 18-64 years, 65+ years. Enrolment: 27.
Status: Ongoing, recruiting. Start date (EU): 2026-01-29. Decision date: 2025-09-23. Results received: No. Last updated: 2026-06-24.

Condition(s): Acute Myeloid Leukemia (AML), Myleodyplastic Neoplasm/Acute Myeloid Leukemia (MDS/AML) and higher risk MDS
Product: Fludarabin HEXAL® 25 mg/ml Konzentrat zur Herstellung einer Injektions- oder Infusionslösung, Trecondi 5 g powder for solution for infusion, Venclyxto 100 mg film-coated tablets

Primary endpoint: Overall Survival (OS) at day 28 after alloHCT
Endpoint(s): Adverse Events ≥ CTCAE grade 4, Non-relapse Mortality (NRM) at day 100 after alloHCT, Overall survival (OS) day 100 after alloHCT, Cumulative Incidence of Relapse (CIR) day 100 after alloHCT, Adverse Events ≥ CTCAE grade 3, Rate of delayed Engraftment at day 28 after alloHCT, Stage and Grade of acute GVHD at day 100 after alloHCT, Composite Complete Remission (cCR) Rate at day 100 after alloHCT by pathological assessement of bone marrow biopsy** and peripheral blood count, Rate of MRD-negativity at day 100 after alloHCT by flow cytometric assessment, Rate of MRD-negativity at day 100 after alloHCT by qPCR, Rate of complete Donor Chimersim, Rate of patients with >50/µl T-helper cells at day 100 after alloHCT by flow cytometric assessment, Health-related Quality of Life at day 100 after alloHCT assessed with FACT-BMT4 and EQ-5D- 5L-VAS5, Cumulative number of hospitalized days at day 100

Source: https://euclinicaltrials.eu/ctis-public/view/2025-521372-62-00